EU clinical trial 2025-521805-41-00: Patient-Centered Study of Trastuzumab Deruxtecan (T-DXd) in First-Line HER2-POsitive Metastatic Breast Cancer with Proactive Toxicity ManagementReflecting Real-World Clinical Practice / TOP-REAL Trial
Protocol code: SOLTI-2402
Sponsor: Solti Group (Pharmaceutical company). Phase: Therapeutic confirmatory (Phase III). Countries: France (authorised, recruitment pending), Germany (authorised, recruiting), Spain (ongoing, recruiting).
Therapeutic area(s): Diseases [C] - Neoplasms [C04]
Gender: Female, Male. Age: 18-64 years, 65+ years. Enrolment: 300.
Start date (EU): 2026-02-18. Decision date: 2026-01-26. Results received: No. Last updated: 2026-08-05.
Decision dates by country: DE: 2026-01-26, FR: 2026-01-27, ES: 2026-01-28

Condition(s): Patients with HER2-positive, locally advanced or metastatic breast cancer (BC), who have not received prior chemotherapy or HER2-targeted therapy for advanced/metastatic disease
Product: Enhertu 100 mg powder for concentrate for solution for infusion, Perjeta 420 mg concentrate for solution for infusion

Primary endpoint: TFST, defined as the time from the date of first dose of the study treatment to the date of i) first subsequent anti-cancer therapy after disease progression or discontinuation of maintenance treatment (in patients who discontinued due to treatment-related toxicities), or ii) death from any cause, whichever occurs first., Time to a 10% physical functioning deterioration based on the EORTC QLQ-C30 Physical Functioning scale.
Endpoint(s): Safety and tolerability will be evaluated in terms of occurrence and severity of AEs, laboratory abnormalities, discontinuation rates, dose reductions/interruptions, median absolute and relative dose intensity, and median treatment duration., Proportion of participants with maintained or improved treatment-related self-reported symptoms (PRO-CTCAE)., Safety and tolerability will be evaluated in terms of occurrence and severity of AEs, laboratory abnormalities, discontinuation rates, dose reductions/interruptions, median absolute and relative dose intensity, and median treatment duration., Type and frequency of concomitant medications administered for AE management or supportive care interventions and number of hospitalizations for SAEs, Percentage of any acute or delayed nausea and vomiting or breakthrough anti-emetic use, in patients receiving prophylactic anti-emetic agents (combination regimen of 3 medicinal products), Composite of ER visits, unplanned hospitalizations and non-programed visits, PFS, defined as the time from the date of first dose to the date of first clinical or radiological progression or death due to any cause, whichever occurs first, as assessed by the investigators’ assessments and according to Response Evaluation Criteria in Solid Tumors (RECIST) version 1.1 criteria., Overall response rate (ORR), defined as the proportion of patients with best overall response of complete response (CR) or partial response (PR) as per local investigator’s assessment and according to RECIST 1.1., Clinical benefit rate (CBR), defined as the proportion of patients with a best overall response of i) CR or PR or ii) SD or Non-CR/Non-PD lasting more than 24 weeks, as per local investigator’s assessment and according to RECIST 1.1., Time to response (TtR), defined as the time from the date of first dose to the first objective tumor response (tumor shrinkage of ≥30%) observed for patients who achieved a CR or PR., Duration of response (DoR), defined as the time from the first occurrence of a documented objective response (CR or PR) to disease progression, as per local investigator’s assessment and according to RECIST 1.1., or death from any cause, whichever occurs first., Proportion of participants experiencing treatment-related symptoms as measured by selected scales from the EORTC QLQ-C30 and EORTC QLQ-BR42., Change from baseline in the global health status (GHS)/QoL scale from the EORTC QLQ-C30 questionnaire version 3.0 and functioning scales scores (including physical and role function)., Time to a 10% deterioration in the GHS/QoL scale and other scales from the EORTC QLQ-C30 questionnaire version 3.0., Adherence to digital health tools (ePRO surveys and oximeter measurements), System usability scale, quality of care, quality of communication and overall satisfaction (ad hoc questionnaire encompassing all these domains), Reach and adoption rates, alert rate, and time for Healthcare Professionals (HCPs) to handle alerts, clinical actions taken by HCPs to manage alerts, education content consumption, start and completion of self-management modules (Resilience only); duration of monitoring, number and frequency of visits triggered by the digital systems used over the course of therapy (CANKADO only)., Comparative studies of outcome factors (e.g. physical functioning scale, global health status, pain symptom, TTD, digital adherence) in subgroups defined by individual patient characteristics, population, and software solution.

Source: https://euclinicaltrials.eu/ctis-public/view/2025-521805-41-00